EU clinical trial 2022-502305-15-00: Open label dose-escalation and dose-expansion study to evaluate the safety, expansion, persistence and clinical activity of UCART22 (allogeneic engineered T-cells expressing Anti-CD22 Chimeric Antigen Receptor) in patients with relapsed or refractory CD22+ B-cell Acute Lymphoblastic Leukemia (B-ALL)
Protocol code: BALLI-01;UCART22_01
Sponsor: Cellectis (Pharmaceutical company). Phase: Phase I and Phase II (Integrated)- First administration to humans. Countries: France (ongoing, recruitment ended), Italy (authorised, recruitment pending), Spain (authorised, recruitment pending).
Therapeutic area(s): Diseases [C] - Neoplasms [C04]
Gender: Female, Male. Age: 0-17 years, 18-64 years. Enrolment: 100.
Start date (EU): 2025-11-26. Decision date: 2023-07-27. Results received: No. Last updated: 2026-07-21.
Decision dates by country: IT: 2024-03-27, ES: 2024-05-23, FR: 2023-07-27

Condition(s): Relapsed or refractory B-cell Acute Lymphoblastic Leukemia
Product: ENDOXAN 1000 mg, poudre pour solution injectable, UCART22, MabThera 1400 mg solution for subcutaneous injection, LEMTRADA 12 mg concentrate for solution for infusion, Fludara 50 mg poudre pour solution injectable ou poudre pour solution pour perfusion, CLLS52

Primary endpoint: Phase 1 Dose escalation: Incidence, nature and severity of adverse events and serious adverse events (SAEs); Incidence, nature, and severity of adverse events and SAEs associated with lymphodepletion, Phase 1 Dose Escalation: Proportion of subjects in each dose level cohort with dose-limiting toxicity during the DLT observation period, Phase 1 Sub-study FCA: Incidence, nature and severity of AEs and SAEs throughout the study; Incidence, nature, and severity of AEs and SAEs associated with FCA lymphodepletion, Phase 2 LD Optimization: Proportion of subjects achieving CR or CRi with incomplete hematologic recovery, evaluated within 3 months (from Day 28 to Day 84) as assessed by an IRRC according to the Response Criteria for ALL, Phase 2 Dose Expansion: Proportion of subjects achieving a CR or CRi, evaluated within 3 months (from Day 28 to Day 84) as assessed by an IRRC according to the Response Criteria for ALL
Endpoint(s): Phase 1: Investigator-assessed overall response rate, Phase 1: Investigator assessed rate of minimal residual disease negativity, Phase 1: Time to Event Endpoints: Progression free survival (PFS); overall survival (OS) and duration of response (DoR), Phase 1: Proportion of subjects who achieve adequate response and proceed to hematopoietic stem cell transplant (HSCT) without additional antileukemia therapy, Phase 1: Incidence, nature, and severity of AEs and SAEs, Phase 2: Proportion of subjects (all of whom were transplant-ineligible at study entry) who transition to transplant eligible, as assessed by the investigator, Phase 2: Duration of CR/CRi with or without censoring for transplant, Phase 2: Duration of molecular MRD-negative response (mDOR), Phase 2: Overall Response Rate according to the Response Criteria for ALL, Phase 2: Overall Survival, Phase 2: Incidence, nature and severity of AEs and SAEs, Phase 2: Changes overtime on quality of life

Source: https://euclinicaltrials.eu/ctis-public/view/2022-502305-15-00